EU clinical trial 2025-522864-34-00: Peri-operative intraperitoneal irinotecan and systemic FLOT in the curative treatment of gastric cancer and gastroesophageal junction cancer: a phase I study
Sponsor: Erasmus Universitair Medisch Centrum Rotterdam (Erasmus MC) (Hospital/Clinic/Other health care facility). Phase: Human Pharmacology (Phase I)- Other. Countries: Netherlands (ongoing, recruiting).
Therapeutic area(s): Diseases [C] - Neoplasms [C04]
Gender: Female, Male. Age: 18-64 years, 65+ years. Enrolment: 18.
Status: Ongoing, recruiting. Start date (EU): 2026-03-30. Decision date: 2026-03-16. Results received: No. Last updated: 2026-03-16.

Condition(s): Gastric cancer
Product: Irinotecan Accord 20 mg/ml concentraat voor oplossing voor infusie

Primary endpoint: The MTD will be established using a 3+3 dose escalation design in which the amount of DLTs will determine the MTD
Endpoint(s): Safety of the administered treatment, assessed by: - All treatment-related adverse events (AEs) according to CTCAE; - All serious adverse events (SAEs); - All postoperative complications, Percentage of patients discontinuing treatment due to treatment-related adverse events • Percentage of patients getting to resection after preoperative chemotherapy, Assessed by the pharmacokinetic parameters and peritoneum/plasma ratio during the second treatment cycle, Assessed by comparing UGT1A1 genotype and pharmacokinetic parameters in the peritoneal cavity

Source: https://euclinicaltrials.eu/ctis-public/view/2025-522864-34-00